EU clinical trial 2023-503613-29-00: Efficacy and safety of octreotide in laparoscopic hepatectomy surgery: effect on blood loss, need for vasoactive drugs, transfusion requirement.
Protocol code: HEPA-OCT
Sponsor: University Clinic Of Navarra (Hospital/Clinic/Other health care facility). Phase: Therapeutic exploratory (Phase II). Countries: Spain (ongoing, recruiting).
Therapeutic area(s): Analytical, Diagnostic and Therapeutic Techniques and Equipment [E] - Anesthesia and Analgesia [E03]
Gender: Female, Male. Age: 18-64 years, 65+ years. Enrolment: 62.
Status: Ongoing, recruiting. Start date (EU): 2023-07-18. Decision date: 2023-06-20. Results received: No. Last updated: 2023-06-20.

Condition(s): Laparoscopic hepatectomy surgery
Product: OCTREOTIDE

Primary endpoint: The main objective of the trial is the reduction of intraoperative bleeding, which will be measured through milliliters of blood lost at the end of surgery, decrease in hemoglobin, hematocrit, platelets and fibrinogen values.
Endpoint(s): Changes in heart rate and blood pressure during surgery., Need for transfusion of blood products during surgery and later during the immediate perioperative 24-72h., Need for the use of vasoactive drugs during surgery and if needed, we will indicate when they can be withdrawn., Number of clampings and their duration with monitoring of hemodynamic stability during surgery., Hepatic function and its recovery after surgery, control of hemogram and coagulation after 24h, at discharge and at 3 months., Evaluation of admissions after surgery up to three months later related to any post-surgical complication.

Source: https://euclinicaltrials.eu/ctis-public/view/2023-503613-29-00